EU clinical trial 2024-511365-11-00: A Phase 3, Global, Multi-Center, Double-Blind, Randomized, Efficacy Study of Zolbetuximab (IMAB362) Plus mFOLFOX6 Compared with Placebo Plus mFOLFOX6 as First-line Treatment of Subjects with Claudin (CLDN)18.2-Positive, HER2-Negative, Locally Advanced Unresectable or Metastatic Gastric or Gastroesophageal Junction (GEJ) Adenocarcinoma
Protocol code: 8951-CL-0301
Sponsor: Astellas Pharma Global Development Inc. (Pharmaceutical company). Phase: Therapeutic confirmatory (Phase III). Countries: Italy (ended), Spain (ongoing, recruitment ended), Poland (ended), Belgium (ended), Germany (ended), France (ended).
Therapeutic area(s): Diseases [C] - Neoplasms [C04]
Gender: Female, Male. Age: 18-64 years, 65+ years. Enrolment: 210.
Start date (EU): 2018-11-27. Decision date: 2024-07-23. Results received: No. Last updated: 2026-01-15.
Decision dates by country: BE: 2024-07-23, FR: 2024-09-13, IT: 2024-07-29, ES: 2024-07-23, DE: 2024-07-26, PL: 2024-07-24

Condition(s): Metastatic Gastric or Gastroesophageal Junction (GEJ) Adenocarcinoma
Product: ASP8951, Sodium Chloride 0.9% Intravenous Infusion BP

Primary endpoint: The primary endpoint is PFS, which is defined as the time from the date of randomization until the date of radiological PD (per Response Evaluation Criteria In Solid Tumors [RECIST] 1.1 by independent review committee [IRC]) or death from any cause, whichever is earliest
Endpoint(s): OS, defined as the time from the date of randomization until the date of death from any cause, Time to confirmed deterioration (TTCD) using the PF, OG25-Pain and GHS/QoL scores as measured by EORTC QLQ-C30 and QLQ-OG25. TTCD is defined as time to first confirmed deterioration, i.e., time from randomization to first clinically meaningful deterioration that is confirmed at the next scheduled visit, ORR, defined as the proportion of subjects who have a best overall response (BOR) of CR or PR as assessed by IRC per RECIST 1.1, DOR, defined as the time from the date of the first response (CR/PR) until the date of PD as assessed by IRC per RECIST 1.1 or date of death from any cause, whichever is earliest, Safety and tolerability, as measured by AEs, laboratory test results, vital signs, ECGs and Eastern Cooperative Oncology Group (ECOG) performance status, HRQoL using the additional parameters as measured by EORTC QLQC30, QLQ-OG25 plus GP and EQ5D-5L questionnaire, Pharmacokinetics of zolbetuximab Ctrough, Immunogenicity of zolbetuximab as measured by the frequency of antidrug antibody (ADA) positive subject

Source: https://euclinicaltrials.eu/ctis-public/view/2024-511365-11-00